EU clinical trial 2025-522883-34-00: PROTECx - Pembrolizumab Registry for Outcomes and Treatment Evaluation in Cervical Cancer
Protocol code: 22590
Sponsor: Universitair Medisch Centrum Groningen (Hospital/Clinic/Other health care facility). Phase: Therapeutic use (Phase IV). Countries: Netherlands (ongoing, recruiting).
Therapeutic area(s): Diseases [C] - Neoplasms [C04]
Gender: Female. Age: 18-64 years, 65+ years. Enrolment: 261.
Status: Ongoing, recruiting. Start date (EU): 2026-06-12. Decision date: 2026-05-11. Results received: No. Last updated: 2026-05-11.

Condition(s): Metastatic cervical cancer
Product: Avastin 25 mg/ml concentrate for solution for infusion., KEYTRUDA 25 mg/mL concentrate for solution for infusion.

Primary endpoint: PFS: The time from start of first line treatment to the first documented disease progression or death due to any cause, whichever occurs first.
Endpoint(s): PFS-12 & PFS-24: The proportion of participants that are PFS event-free at 12 and 24 months for the complete cohort; the observation cohort and the discontinuation cohort separately and the different response outcomes (SD/PR/CR)., The time from start of first line treatment to death due to any cause for the complete cohort and separately for the observation cohort and the discontinuation cohort., The ORR is defined as the proportion of patients with CR and PR. This will be assessed for the complete cohort and separately for the observation cohort and the discontinuation cohort, The DoR is defined as the time from the first documented evidence of CR or PR until the first documented disease progression or death due to any cause, whichever occurs. It will be evaluated for the total cohort and separately for the observation cohort and the discontinuation cohort, • The percentage of patients of which irAEs led to discontinuation or interruption (≥12 weeks) of treatment during (rechallenge of) PD-1 blockade separately for the observation cohort and discontinuation cohort • The percentage of patients that develop immune-related endocrinopathies separately for the observation cohort and discontinuation cohort, The change in QoL will be assessed at different time points (according to Table 1.) and will be reported in a descriptive manner

Source: https://euclinicaltrials.eu/ctis-public/view/2025-522883-34-00